EU clinical trial 2023-504584-16-00: Early initiated vasopressor therapy vs. standard care of primarily fluid therapy in hypotensive patients in the emergency department – A pragmatic, multi-center, superiority, randomized controlled trial
Sponsor: Odense University Hospital (Hospital/Clinic/Other health care facility). Phase: Therapeutic confirmatory (Phase III). Countries: Denmark (ongoing, recruiting), Sweden (ongoing, recruiting).
Therapeutic area(s): Diseases [C] - Pathological Conditions, Signs and Symptoms [C23]; Diseases [C] - Cardiovascular Diseases [C14]
Gender: Female, Male. Age: 18-64 years, 65+ years. Enrolment: 440.
Status: Ongoing, recruiting. Start date (EU): 2023-12-08. Decision date: 2023-09-11. Results received: No. Last updated: 2025-04-25.
Decision dates by country: DK: 2023-09-11, SE: 2025-04-25

Condition(s): Hypotension, Shock
Product: NOREPINEPHRINE

Primary endpoint: The primary outcome is the proportion of patients achieving either SBP >100 mmHg or MAP > 65 mmHg or a target blood pressure set by the treating physician at 90 (±15) minutes after inclusion.
Endpoint(s): Number of ICU free days alive within 30 days, Time without shock within 24 hours, 30-day all-cause mortality., In-hospital all-cause mortality

Source: https://euclinicaltrials.eu/ctis-public/view/2023-504584-16-00